EU clinical trial 2023-506977-36-00: Pragmatic Randomized Trial to Evaluate the Effectiveness of High-Dose Quadrivalent Influenza Vaccine vs. Standard-Dose Quadrivalent Influenza Vaccine in adults aged 65 to 79 years in Galicia, Spain
Protocol code: GALFLU
Sponsor: Complexo Hospitalario Universitario De Santiago (Hospital/Clinic/Other health care facility). Phase: Therapeutic use (Phase IV). Countries: Spain (ongoing, recruiting).
Therapeutic area(s): Diseases [C] - Virus Diseases [C02]
Gender: Female, Male. Age: 65+ years. Enrolment: 114011.
Status: Ongoing, recruiting. Start date (EU): 2023-10-26. Decision date: 2023-09-13. Results received: No. Last updated: 2023-09-13.

Condition(s): Prevention of influenza infection in adults aged 65-79 years
Product: Influvac Tetra suspensión inyectable en jeringa precargada (vacuna antigripal inactivada de antígenos de superficie), Efluelda, suspensión inyectable en jeringa precargada Vacuna antigripal tetravalente (virus fraccionados, inactivados), 60 microgramos HA/cepa

Primary endpoint: The primary endpoint of the study is the occurrence of a hospitalization due to influenza or pneumonia [composite endpoint].
Endpoint(s): The secondary endpoints of the study are as follows: 1. Hospitalization for any cardio-respiratory disease [composite endpoint] 2. All-cause hospitalization 3. All-cause mortality 4. Hospitalization for influenza 5. Hospitalization for pneumonia

Source: https://euclinicaltrials.eu/ctis-public/view/2023-506977-36-00